EU clinical trial 2024-515263-60-00: TURN-COVID Biobank: The Dutch cohort study tor the evaluation of the use of neutralizing monoclonal antibodies and other antiviral agents against SARS-CoV-2
Protocol code: NL78705.018.21
Sponsor: Stichting Amsterdam UMC (Hospital/Clinic/Other health care facility). Phase: Therapeutic use (Phase IV). Countries: Netherlands (ended).
Therapeutic area(s): Diseases [C] - Respiratory Tract Diseases [C08]; Diseases [C] - Virus Diseases [C02]
Gender: Female, Male. Age: 18-64 years, 65+ years. Enrolment: 400.
Status: Ended. Start date (EU): 2024-11-22. End date (EU): 2025-05-25. Decision date: 2024-11-22. Results received: No. Last updated: 2024-11-22.

Condition(s): SARS-CoV-2 infection
Product: Ronapreve 300 mg + 300 mg solution for injection/infusion, EVUSHELD 150 mg + 150 mg solution for injection, Xevudy 500 mg concentrate for solution for infusion, Paxlovid 150 mg + 100 mg film-coated tablets

Primary endpoint: What are the SARS-CoV-2 viral load kinetics during and after treatment with neutralizing monoclonal antibodies and other antiviral agents against SARS-CoV-2 and the occurence of SARS-CoV-2 infection when used as a prophylactic?, Do viral variants, spike mutations and immune escape occur during treatment with neutralizing monoclonal antibodies and other antiviral agents against SARS-CoV-2?, What are the viral antibody and inflammatory response kinetics during and after treatment with neutralizing monoclonal antibodies and other antiviral agents against SARS-CoV-2?, To create a biobank to address future questions regarding the current use of neutralizing monoclonal antibodies and other antiviral agents against SARS-CoV-2 compared to novel COVID-19 treatments which are in development.

Source: https://euclinicaltrials.eu/ctis-public/view/2024-515263-60-00